EU clinical trial 2025-525111-17-00: A Phase 1b/2a first-in-human, multicentre, randomized, double-blind, placebo-controlled study of multiple ascending dose (Part1) followed by an open-label extension (Part2) to assess the safety, tolerability, and pharmacokinetics of intrathecally administered S233107 in participants with spinocerebellar ataxia type 3
Protocol code: S233107-284
Sponsor: Institut De Recherches Internationales Servier IRIS (Pharmaceutical company). Phase: Phase I and Phase II (Integrated)- First administration to humans. Countries: France (authorised, recruitment pending), Denmark (authorised, recruitment pending), Spain (authorised, recruitment pending), Portugal (authorised, recruitment pending).
Therapeutic area(s): Diseases [C] - Nervous System Diseases [C10]
Gender: Female, Male. Age: 18-64 years. Enrolment: 50.
Status: Authorised, recruitment pending. Decision date: 2026-07-30. Results received: No. Last updated: 2026-08-05.
Decision dates by country: DK: 2026-08-05, FR: 2026-08-05, PT: 2026-07-30, ES: 2026-07-31

Condition(s): Spinocerebellar ataxia type 3
Product: S233107 Solution for injection 15 mg/mL, S233107 Solution for injection 4 mg/mL, Placebo matching S233107

Primary endpoint: Part 1 and 2: - Incidence and severity of AEs - Incidence of abnormalities in 12-lead ECG, clinical laboratory assessments in blood and CSF, vital signs, weight, and suicide risk.
Endpoint(s): Part 1 and 2: - Concentrations and derived PK parameters of S233107 in CSF and plasma, including but not limited to CSF Ctrough, plasma Cmax and plasma AUC0-tau.

Source: https://euclinicaltrials.eu/ctis-public/view/2025-525111-17-00